EU clinical trial 2023-506827-26-00: Long-term effects of semaglutide on diabetic retinopathy in subjects with type 2 diabetes (FOCUS)
Protocol code: NN9535-4352
Sponsor: Novo Nordisk A/S (Pharmaceutical company). Phase: Therapeutic confirmatory (Phase III). Countries: Portugal (ongoing, recruitment ended), Poland (ongoing, recruitment ended), Spain (ongoing, recruitment ended), Romania (ongoing, recruitment ended), Czechia (ended), Germany (ongoing, recruitment ended), Latvia (ongoing, recruitment ended), Bulgaria (ongoing, recruitment ended), Slovakia (ongoing, recruitment ended), Greece (ongoing, recruitment ended).
Therapeutic area(s): Diseases [C] - Nutritional and Metabolic Diseases [C18]
Gender: Female, Male. Age: 18-64 years, 65+ years. Enrolment: 589.
Start date (EU): 2019-05-02. Decision date: 2024-02-12. Results received: No. Last updated: 2026-06-26.
Decision dates by country: CZ: 2024-02-19, SK: 2024-02-13, GR: 2024-03-22, BG: 2024-03-21, DE: 2024-02-15, LV: 2024-02-13, PL: 2024-02-16, RO: 2024-02-15, PT: 2024-02-12, ES: 2024-02-19

Condition(s): While it is well-established that long-term good glycaemic control will reduce the risk of diabetic retinopathy development and progression, intensification of glycaemic control has also been associated with an initial worsening of diabetic retinopathy. This phenomenon is known as “early worsening”. The rationale of this trial is to establish the long-term effects of semaglutide on diabetic retinopathy in subjects with type 2 diabetes (T2D) using validated and standardised ophthalmic assessments. This trial is a post-authorisation safety study (PASS) conducted as a commitment to the European Medicines Agency
Product: Ozempic 1 mg solution for injection in pre-filled pen, Semaglutide placebo, solution for injection in 1.5 mL pre-filled PDS290 pen injector

Primary endpoint: Presence of ≥3 steps ETDRS subject level progression at year 5 (yes/no).
Endpoint(s): Time from randomisation to first ≥3 steps ETDRS subject level progression or ciDME in either eye (month)., Supportive secondary endpoints, Change from baseline at year 5 in:, Visual acuity in the worse seeing eye (number of letters), Visual acuity in the better seeing eye (number of letters), Occurrence of treatment for diabetic retinopathy or diabetic macular oedema in either eye during the period from randomisation to year 5 with:, Focal/grid laser photocoagulation (yes/no), Pan-retinal laser photocoagulation (yes/no), Intravitreal injection with anti-VEGF (yes/no), Intravitreal injection with steroid (yes/no), Vitrectomy (yes/no), Presence of:, ≥3 steps ETDRS subject level improvement at year 5 (yes/no), ≥2 steps ETDRS subject level progression at year 5 (yes/no), ≥2 steps ETDRS subject level improvement at year 5 (yes/no), Persistent visual acuity ≤38 ETDRS letters in either eye at year 5 (yes/no), Persistent ≥2 lines (10 letters) ETDRS worsening in visual acuity in either eye from baseline at year 5 (yes/no, Persistent ≥3 lines (15 letters) ETDRS worsening in visual acuity in either eye from baseline at year 5 (yes/no), Persistent ≥2 lines (10 letters) ETDRS improvement in visual acuity in either eye from baseline at year 5 (yes/no), Persistent ≥3 lines (15 letters) ETDRS improvement in visual acuity in either eye from baseline at year 5 (yes/no), ciDME in either eye at year 5 (yes/no), Change from baseline at year 5 in:, HbA1c (%-point), Body weight (kg), Systolic and diastolic blood pressure (mmHg), Lipids: Total-cholesterol, HDL-cholesterol, LDL-cholesterol and triglycerides (mmol/L)

Source: https://euclinicaltrials.eu/ctis-public/view/2023-506827-26-00